EU clinical trial 2024-520375-27-00: A phase 2, two-part study to assess the safety, antiviral biomarker responses, and efficacy of inhaled SNG001 for the treatment of patients with a confirmed respiratory virus infection undergoing invasive mechanical ventilation
Protocol code: SG021
Sponsor: Synairgen Research Limited (Pharmaceutical company). Phase: Therapeutic exploratory (Phase II). Countries: Netherlands (ended), France (ended), Spain (ended), Belgium (ended).
Therapeutic area(s): Diseases [C] - Virus Diseases [C02]
Gender: Female, Male. Age: 18-64 years, 65+ years. Enrolment: 134.
Status: Ended. End date (EU): 2026-03-13. Decision date: 2025-10-15. Results received: No. Last updated: 2026-01-13.
Decision dates by country: BE: 2025-10-16, NL: 2025-10-16, ES: 2025-10-15, FR: 2025-10-17

Condition(s): Lower respiratory tract viral infections
Product: SNG001, Placebo to match SNG001 (Interferon beta-1a 12MIU/mL solution for inhalation)

Primary endpoint: Part 1: The occurrence and severity of adverse events (AEs), and serious adverse events (SAEs), including pre-specified respiratory and cardiovascular deteriorations., Part 2: All-cause mortality within 28 days from randomisation.
Endpoint(s): 1. Part 2: The occurrence and severity of AEs and SAEs, including pre-specified respiratory and cardiovascular deteriorations., 2. Part 2: Change from baseline in modified Sequential Organ Failure Assessment (mSOFA) score during ICU stay., 3. Part 2: Time to extubation., 4. Part 2: Ventilator-free days over 28 days from randomisation., 5. Part 2: Duration of ICU stay., 6. Part 2: Duration of hospital stay., 7. Part 2: All-cause mortality within 28 days post final dose., 8. Part 2: Alive and free of organ support at 28 days from randomisation and at 28 days post final dose., 9. Part 2: Change in Ordinal Scale for Clinical Improvement (OSCI) score from baseline to 7, 10, 14, and 28 days post randomisation., 10. Part 2: Time to first negative virus test in tracheal aspirates., 11. Part 2: Change from baseline in levels of IFNβ dependent biomarkers in tracheal aspirates.

Source: https://euclinicaltrials.eu/ctis-public/view/2024-520375-27-00